EU clinical trial 2024-516576-15-00: A randomized, double-blinded, placebo-controlled, multicenter, phase II/III efficacy and safety study of oral TherO2-01S22 as add-on therapy on top of first line anti-HER2 targeted treatment of patients with Metastatic Breast Cancer TherO2-01S22 in HER2-positive breast cancer: TherO2-MBC Study
Protocol code: 2022-009
Sponsor: Centre Regional Lutte Contre Le Cancer (Hospital/Clinic/Other health care facility). Phase: Phase II and Phase III (Integrated). Countries: France (authorised, recruitment pending).
Therapeutic area(s): Diseases [C] - Neoplasms [C04]
Gender: Female, Male. Age: 18-64 years, 65+ years. Enrolment: 224.
Status: Authorised, recruitment pending. Decision date: 2025-10-03. Results received: No. Last updated: 2025-12-02.
Decision dates by country: FR: 2025-11-21

Condition(s): metastatic breast cancer
Product: Trazimera 420 mg powder for concentrate for solution for infusion, Perjeta 420 mg concentrate for solution for infusion, VINORELBINE ARROW 10 mg/ml, solution à diluer pour perfusion, TherO2-01S22, PACLITAXEL AHCL 6 mg/ml, solution à diluer pour perfusion, Placebo syrup, Docetaxel Accord 160 mg/8 ml concentrate for solution for infusion

Primary endpoint: Objective response rate (ORR): Percentage of patients whose disease decreased (Partial Response, PR) and / or disappears (Complete Response, CR) after treatment, according to RECIST V1.1 criteria20 and according to the adapted EORTC criteria for 18F-FDG PET-scan : Time Frame: at D43
Endpoint(s): Progression-Free Survival (PFS): defined as the time interval from the date of randomization to the date of progression. Events considered as progression include local or distant progression, appearance of a second cancer or death (all causes) whichever occurs first. Time Frame: every 3 months up to 24 months from randomization, Overall Survival (OS): defined as the time interval from the date of randomization to the date of death, regardless of disease progression. Time Frame: every 3 months up to 24 months from randomization, Safety: Incidence of treatment-related adverse events (AEs) and serious adverse events (SAEs) classified according to the CTCAE v5.0 criteria. Record of all AEs (regardless of imputability) until the safety visit. Time Frame: from randomization to D64, Cardiotoxicity: defined by decrease in Left Ventricular Ejection Fraction (LVEF) value according to the modality performed (cardiac MRI, MUGA scan or echocardiography) and any other cardiac toxicities revealed by physical examination or any other adequate exam (CTCAE v5.0 criteria). Time Frame: every 3 months up to 24 months from randomization, Quality of life: QLQ-C30 and BR23 auto-questionnaire Time Frame: at baseline and D43, Summary of oral TherO2-01S22 pharmacokinetics parameters. PK samples to be collected before IMP or placebo intake, and at 15, 30, 45, 60, 120, 240, 300 min after the intake as detailed in section 10.1. Time Frame: at D-1 of cycle 1 and cycle 2, Summary of trastuzumab/pertuzumab pharmacokinetics parameters. PK samples to be collected prior to trastuzumab/pertuzumab administration as detailed in section 10.2. Time Frame: at D1 of cycle 2 and at D43 (corresponding to the day 1 of cycle 3 of trastuzumab/pertuzumab

Source: https://euclinicaltrials.eu/ctis-public/view/2024-516576-15-00